EU clinical trial 2024-514042-36-00: Combination lock01 - Impact of aminoglycosides-based antibiotics combination and protective isolation on outcomes in critically-ill neutropenic patients with sepsis:A randomized 2 by 2 factorial design randomized pragmatic trial
Protocol code: APHP180690
Sponsor: Assistance Publique Hopitaux De Paris (Hospital/Clinic/Other health care facility). Phase: Therapeutic confirmatory (Phase III). Countries: France (ongoing, recruiting).
Therapeutic area(s): Diseases [C] - Virus Diseases [C02]; Diseases [C] - Bacterial Infections and Mycoses [C01]
Gender: Female, Male. Age: 18-64 years, 65+ years. Enrolment: 340.
Status: Ongoing, recruiting. Start date (EU): 2022-09-21. Decision date: 2024-08-01. Results received: No. Last updated: 2026-04-09.

Condition(s): Adult patients admitted to intensive care
Product: AMIKACIN

Primary endpoint: Day-90 mortality
Endpoint(s): Day-28 and hospital mortality, Incidence and severity of AKI according to KDIGO definition, Major Adverse Kidney Events at day-28 and day 90 (composite of death, new renal replacement therapy, or persistent renal dysfunction), Incidence of clinically apparent loss of hearing at end of ICU stay and day 90, Rate of adherence to adequate hand hygiene as assessed by external observer, Incidence density of selected serious adverse events including unexpected cardiac arrest, Incidence density of new bacterial, viral or fungal episode, Number of days free from organ support therapy (mechanical ventilation, vasopressors or RRT) at day 28, Rate of clinical cure, Frequency of initial antibiotic therapy inadequate as regard to microbiological documentation., Number of day free of antibiotic therapy at day-28, Duration of aminoglycoside therapy, rate of aminoglycoside overdosage according to residual concentration and overuse when compared to experts recommendations

Source: https://euclinicaltrials.eu/ctis-public/view/2024-514042-36-00